EU clinical trial 2022-502982-49-00: A Phase 2, Randomized, Open-Label, Study of Lorigerlimab with Docetaxel or Docetaxel Alone in Participants with Metastatic Castration-Resistant Prostate Cancer
Protocol code: CP-MGD019-02
Sponsor: Macrogenics Inc. (Pharmaceutical company). Phase: Therapeutic exploratory (Phase II). Countries: Spain (ended), Poland (ended), Belgium (ended), Bulgaria (ended), France (ended).
Therapeutic area(s): Diseases [C] - Neoplasms [C04]
Gender: Male. Age: 18-64 years, 65+ years. Enrolment: 92.
Status: Ended. Start date (EU): 2024-07-15. End date (EU): 2026-03-16. End date: 2026-03-17. Decision date: 2023-09-26. Results received: No. Last updated: 2026-05-18.
Decision dates by country: PL: 2023-10-02, BG: 2023-10-02, BE: 2023-09-26, FR: 2023-09-27, ES: 2023-10-02

Condition(s): Metastatic Castration-Resistant Prostate Cancer
Product: Dexamethason 4 mg JENAPHARM®, Docetaxel AqVida 20 mg/ml Konzentrat zur Herstellung einer Infusionslösung, MGD019, Prednisona KERN PHARMA 5 mg comprimidos EFG

Primary endpoint: Median radiographic progression free survival (rPFS) determined by investigator review.
Endpoint(s): Objective response rate (ORR) per PCWG3 criteria, Duration of response (DoR), Time to response (TTR), PSA50 response rate, PSA90 response rate, Time to PSA progression, Duration of PSA response, Overall survival (OS), Time to First Symptomatic Skeletal Event (SSE), Time to pain progression using the BPI-sf questionnaire, Pain severity using the Brief Pain Index - short form (BPI-sf) questionnaire, Pain interference using the BPI-sf questionnaire, Functional Assessment of Cancer Therapy-Prostate (FACT-P) questionnaire, Comparison of types of adverse events (AEs) between treatment groups, Lorigerlimab maximum concentration or concentration at the end of infusion (Cmax), Lorigerlimab area under the concentration time curve (AUC), Trough drug concentration (Ctrough or Cmin), Clearance (CL), Volume of distribution (Vz), Terminal half-life, Number of participants who develop anti-drug antibodies

Source: https://euclinicaltrials.eu/ctis-public/view/2022-502982-49-00